EU clinical trial 2023-508724-35-00: TRIFLUOX-DP: Safety of Trifluridine/tipiracil as replacement of fluoropyrimidines (5-fluorouracil and capecitabine) based chemotherapy as first line metastatic colorectal or gastroesophageal cancer regimens in patients with dihydropyrimidine dehydrogenase deficiency: a phase II trial
Protocol code: UC-GIG-2308
Sponsor: Unicancer (Hospital/Clinic/Other health care facility). Phase: Therapeutic exploratory (Phase II). Countries: France (ongoing, recruiting).
Therapeutic area(s): Diseases [C] - Neoplasms [C04]
Gender: Female, Male. Age: 18-64 years, 65+ years. Enrolment: 73.
Status: Ongoing, recruiting. Start date (EU): 2024-12-10. Decision date: 2024-07-26. Results received: No. Last updated: 2026-07-06.

Condition(s): Patients with pMMR/MSS metastatic adenocarcinoma of the colon or rectum or gastroesophageal cancer (lower esophagus, gastroesophageal junction and gastric) and with known dihydropyrimidine dehydrogenase (DPD) deficiency defined as plasma uracil concentration ≥16 ng/ml, who undergo first-line treatment
Product: TRASTUZUMAB, KEYTRUDA 25 mg/mL concentrate for solution for infusion., BEVACIZUMAB, NIVOLUMAB, Lonsurf 15 mg/6.14 mg film-coated tablets, PANITUMUMAB, OXALIPLATIN, Lonsurf 20 mg/8.19 mg film-coated tablets

Primary endpoint: The co-primary endpoint including: the rate of patients without specific toxicities defined as grade 3-4-5 digestive toxicities (diarrhoea and/or stomatitis) and grade 4-5 neutropenia or febrile neutropenia over the first 2 cycles (1 month of treatment) of first-line metastatic treatment (NCI CTCAE v5.0) AND the disease control rate after the 1st evaluation at 2 months of treatment.
Endpoint(s): Safety of combination treatment (NCI CTCAE v5.0) determined through the incidence of adverse events, treatment-related adverse events, serious adverse events (SAE), and death; for the whole population and depending on glomerular filtration rate ([50-60[ vs [60- 90[ vs ≥90 mL/min per 1.73 m2), Dose intensity of combination treatment per patient and per cycle for cycle 1 and cycle 2 before third cycle, Treatment efficacy : PFS, Overall survival, Objective response rate, Disease control rate, Health-related quality of life will be assessed using the EORTC QLQ-C30 and EORTC QLQ-OG25 questionnaires for patients with gastroesophageal adenocarcinomas or EORTC QLQ-CR29 for patients with colorectal adenocarcinomas at baseline and every 2 months until disease progression and/or at least 3 months after study treatment stop

Source: https://euclinicaltrials.eu/ctis-public/view/2023-508724-35-00